EU clinical trial 2024-516287-29-00: A Study to Test the Activity and Safety of Vixarelimab in Patients with Moderate to Severe Active Ulcerative Colitis
Protocol code: GA45735
Sponsor: Genentech Inc. (Pharmaceutical company). Phase: Human Pharmacology (Phase I)- Other. Countries: Germany (ongoing, recruitment ended).
Therapeutic area(s): Diseases [C] - Digestive System Diseases [C06]
Gender: Female, Male. Age: 18-64 years, 65+ years. Enrolment: 24.
Status: Ongoing, recruitment ended. Start date (EU): 2025-02-26. Decision date: 2024-12-18. Results received: No. Last updated: 2025-10-22.

Condition(s): Moderate to Severe Active Ulcerative Colitis (UC)

Source: https://euclinicaltrials.eu/ctis-public/view/2024-516287-29-00